EU clinical trial 2022-502907-31-00: A Phase II study evaluating efficacy of KTE-X19 CAR-T cell therapy in Relapsed or Refractory Mantle-Cell Lymphoma achieving a partial response during Ibrutinib salvage therapy
Protocol code: PRIMACART
Sponsor: Fondazione IRCCS Istituto Nazionale Dei Tumori (Hospital/Clinic/Other health care facility). Phase: Therapeutic exploratory (Phase II). Countries: Italy (expired).
Therapeutic area(s): Diseases [C] - Hemic and Lymphatic Diseases [C15]; Diseases [C] - Neoplasms [C04]
Gender: Female, Male. Age: 18-64 years, 65+ years. Enrolment: 20.
Status: Expired. Start date (EU): 2023-12-28. Decision date: 2023-06-08. Results received: No. Last updated: 2025-01-16.

Condition(s): Relapsed or Refractory Mantle-Cell Lymphoma
Product: IMBRUVICA 140 mg hard capsules, FLUDARABINE, IMBRUVICA 140 mg hard capsules, Tecartus 0.4 - 2 × 10e8 cells dispersion for infusion, CYCLOPHOSPHAMIDE

Primary endpoint: CR rate at 90 days after KTE-X19 infusion in patients in PR after Ibrutinib single agent therapy
Endpoint(s): 12 months PFS, 12 months OS, 24 and 36 months PFS, 24 and 36 months OS, DOR, CR rate at 180 days and 365 days after KTE-X19 infusion, NRM, Rates of CRS and ICANS [graded according to the American Society for Transplantation and Cellular Therapy (ASTCT) Grading System], including description of the use of tocilizumab, corticosteroids and other treatments for their management, rate of HLH/MAS and other AEs [graded according to the Common Terminology Criteria for Adverse Events version 5.0 (CTCAEv5)], Rate of MRD negativity for those patients with bone marrow (BM) involvement at study entry, ORR/CR rates at 90 days after KTE-X19 infusion for patients with poor clinical and biological risk factors including POD24, high Ki-67 levels, blastoid/pleomorphic morphology and TP53 mutations/deletions

Source: https://euclinicaltrials.eu/ctis-public/view/2022-502907-31-00